EU clinical trial 2024-515844-22-00: PROSPECTIVE RANDOMIZED CLINICAL TRIAL OF EARLY OXYBUTININ TREATMENT FOR BOYS WITH POSTERIOR URETHRAL VALVES - PRETIPUV -
Protocol code: CHUBX 2018/65
Sponsor: Centre Hospitalier Universitaire De Bordeaux (Hospital/Clinic/Other health care facility). Phase: Therapeutic exploratory (Phase II). Countries: France (ongoing, recruiting).
Therapeutic area(s): Diseases [C] - Male Urogenital Diseases [C12]
Gender: Male. Age: 0-17 years. Enrolment: 50.
Status: Ongoing, recruiting. Start date (EU): 2020-09-10. Decision date: 2024-10-01. Results received: No. Last updated: 2026-04-08.

Condition(s): urethral posterior valve
Product: PMS-Oxybutynin

Primary endpoint: Composite endpoint where the success of treatment at 9 months after treatment inclusion is defined by the association of the three following events: - Bladder compliance >10mL/cmH2O AND - Voiding pressure <60 cmH2O AND - Bladder Volume ≥70% of theoretical value
Endpoint(s): Proportion and type of adverse events in each group, Incidence of urinary tract infections in each group, Compliance with treatment will be evaluated through the proportion of oxybutynin treatment interruption, Sonographic changes will be expressed as a degree of hydronephrosis at 12-15 months of life (9 months after inclusion), AUC, Cmax, Cmin and half-life of oxybutynin and desethyloxybutynin (active metabolite) in treated boys over treatment. Pharmacokinetic samples (6 points from Cmin to H+3h) at 2 weeks, 3 and 9 months after inclusion will be used to study and determine the pharmacokinetic parameters. In order to avoid having to take blood sample from the child several times, it is proposed to use a small venous catheter during the time of the pharmacokinetic samples., Creatinine clearance in each group

Source: https://euclinicaltrials.eu/ctis-public/view/2024-515844-22-00